EU clinical trial 2024-520381-62-00: Phase IV, multicenter, single-arm clinical trial to evaluate the effect on the evolution of the severity of onychomycosis and quality of life in patients treated with DexULac®.
Protocol code: RJ-DEX01
Sponsor: Laboratorio Reig Jofre S.A. (Pharmaceutical company). Phase: Therapeutic use (Phase IV). Countries: Spain (ongoing, recruitment ended).
Therapeutic area(s): Diseases [C] - Bacterial Infections and Mycoses [C01]
Gender: Female, Male. Age: 18-64 years, 65+ years. Enrolment: 100.
Status: Ongoing, recruitment ended. Start date (EU): 2025-07-03. Decision date: 2025-05-06. Results received: No. Last updated: 2025-11-21.
Decision dates by country: ES: 2025-07-23

Condition(s): onychomycosis
Product: DexULac 80 mg/g barniz de uñas medicamentoso

Primary endpoint: The clinical evolution of onychomycosis will be evaluated through the mean change in the Onychomycosis Severity Index (OSI) from baseline to 12, 24, 36, 48 and 52 weeks.
Endpoint(s): The evolution of the quality of life of patients with onychomycosis will be evaluated through the mean change in the Dermatology Life Quality Index (DLQI) from baseline to 12, 36, 48 and 52 weeks. The DLQI will be performed at all study visits until clinical success is achieved or after the end of the follow-up period, which will take place within 4 weeks after the last treatment visit, with a maximum period of 52 weeks., Clinical success in patients with onychomycosis will be evaluated according to the percentage of patients in whom a decrease in the area of the diseased nail has been observed < 10% of the total of the first toe evaluated by the investigator using photographic image from the baseline moment until 12, 24, 36, 48 and 52 weeks., Clinical improvement in patients with onychomycosis will be evaluated according to the percentage of patients in whom at least a 20% decrease in the affected area of the nail of the first toe has been observed evaluated by the investigator using photographic image from the baseline moment until 12, 24, 36, 48 and 52 weeks., The time necessary to achieve clinical success will be evaluated according to the number of weeks of treatment that patients have required to achieve clinical success defined as the reduction of the diseased nail area < 10% of the total of the first toe. foot., Mycological cure will be evaluated by the negativization rate of the PCR test in the 4 weeks after the end of treatment. Therefore, PCR will be performed within 4 weeks of the last treatment visit, which will occur at 52 weeks, or within 4 weeks of the last visit at which clinical success was achieved. In the PCR examination, the presence of dermatophyte fungi that cause onychomycosis will be analyzed as an evaluation criterion., The evolution of the patient's perception regarding nail alterations will be evaluated through the average change in the questionnaire for the subjective evaluation of the patient at 12, 36, 48 and 52 weeks of follow-up., The safety profile of treatment with DexULac® will be evaluated according to the total number and frequency of Adverse Events (AEs), serious AEs (SAEs) and Adverse Reactions (ARs) from baseline to 48 weeks of treatment. In addition, the safety profile will be evaluated according to the number and percentage of patients who have experienced at least one of the mentioned events during the 48 weeks of treatment. The severity and causality of each event will also be evaluated.

Source: https://euclinicaltrials.eu/ctis-public/view/2024-520381-62-00